EU clinical trial 2024-515769-32-00: Adjuvant Dynamic marker - Adjusted Personalized Therapy comparing endocrine therapy plus ribociclib versus chemotherapy in intermediate-risk, HR+/HER2- early breast cancer (ADAPTcycle)
Protocol code: WSG-AM08
Sponsor: WSG Women's Cancer Study Group GmbH (Pharmaceutical company). Phase: Therapeutic confirmatory (Phase III). Countries: Germany (ongoing, recruitment ended).
Therapeutic area(s): Diseases [C] - Neoplasms [C04]
Gender: Female. Age: 18-64 years, 65+ years. Enrolment: 1684.
Status: Ongoing, recruitment ended. Start date (EU): 2019-07-02. Decision date: 2024-10-01. Results received: No. Last updated: 2026-07-20.

Condition(s): HR+/HER2- early breast cancer
Product: Kisqali 200 mg film-coated tablets

Primary endpoint: iDFS and dDFS
Endpoint(s): Overall survival (OS) and dDFS,, quality of life (QoL), treatment adherence (measured by drug intake),, local and central Ki-67 values in all tissue samples., Pathological response rate (defined as ypT0/is/ypN0), as well as further definitions (ypT0/ypN0; ypT0/is/any ypN, near pCR (ypT1a/any ypN)),, Clinical response rate (by palpation, ultrasound, and further methods),, Rate of breast-conservation therapy

Source: https://euclinicaltrials.eu/ctis-public/view/2024-515769-32-00